EU clinical trial 2024-519772-10-00: Phase IIB Clinical Trial to evaluate the efficacy and safety of Allogeneic Mesenchymal Stem Cell (MSC) eye injection treatment as therapy for Graft-versus-Host Disease (GvHD) refractory to conventional treatments
Protocol code: TERAV_24-01_EICRxEYE
Sponsor: Fundacion De Investigacion Biomedica De Salamanca (Laboratory/Research/Testing facility). Phase: Therapeutic exploratory (Phase II). Countries: Spain (authorised, recruitment pending).
Therapeutic area(s): Diseases [C] - Eye Diseases [C11]
Gender: Female, Male. Age: 18-64 years, 65+ years. Enrolment: 30.
Status: Authorised, recruitment pending. Decision date: 2025-07-16. Results received: No. Last updated: 2025-11-20.

Condition(s): Dry eye disease in patients with Graft versus Host disease patients
Product: eASC

Primary endpoint: Significant improvement in ocular surface integrity as measured by fluorescein corneal staining. A clinically significant improvement is defined as an improvement in superficial punctate keratitis (SPK) of at least one unit compared to baseline, according to the Oxford scale (range 0-5) and, if there is an epithelial defect, a decrease of at least 3/4 of its initial size., Significant increase in tear production values evaluated with the Schirmer test under topical anesthesia by at least 2 mm., Significant decrease in the degree of conjunctival hyperemia by at least one point (Efron scale, 0-4)., Significant improvement, in at least one point, of the parameters related to the Meibomian glands (Efron scale, 0-4)., Significant improvement of any of the findings in the central cornea, assessed by in vivo confocal microscopy: (a) improvement of at least one grade (3 grades: corneal, mixed, conjunctival) in epithelial phenotype. b) significant decrease in the density of dendritic cells in the corneal stroma; c) improvement in the characteristics of the sub-basal corneal nerve plexus (number of nerves, density, length, tortuosity and nerve branching)., Clinical improvement of symptoms, evaluated with clinical questionnaires (OSDI, mSIDEQ, NRS, WFPRS and CDES-Q). Clinical improvement with at least one of the questionnaires will be considered sufficient.
Endpoint(s): Rate of adverse events related to the application of subconjunctival injection of ASC., Analysis of ocular marker expression in the administered ASCs. To analyze the effect of freezing ASCs in relation to these markers and to establish, if possible, a correlation between the expression of these markers in the applied cells and clinical outcomes., Analysis of the presence and concentration of 48 inflammation-related molecules in tear and serum samples and see their effect on the clinical improvement of patients., Search for new biomarkers that can be used to objectively assess the evolution of patients affected by cRHD and with ocular involvement., Percentage of clinical improvement of the lower dose (6.25 millions of ASCs) compared to the higher dose (12.5 millions of ASCs).

Source: https://euclinicaltrials.eu/ctis-public/view/2024-519772-10-00